EU clinical trial 2025-523674-16-00: A Phase 3, Randomized, Double-Blind, Placebo-Controlled, 3-Arm Study to Investigate the Safety and Tolerability of Efimosfermin Alfa in Participants With Known or Suspected F2- or F3-Stage Metabolic Dysfunction-Associated Steatohepatitis (MASH) (ZENITH-2)
Protocol code: 306246
Sponsor: Glaxosmithkline Research & Development Limited (Pharmaceutical company). Phase: Therapeutic confirmatory (Phase III). Countries: Greece (authorised, recruitment pending), Germany (authorised, recruiting), Belgium (authorised, recruiting), Netherlands (authorised, recruitment pending), Poland (authorised, recruiting), Italy (authorised, recruitment pending), France (authorised, recruiting), Spain (authorised, recruitment pending), Bulgaria (authorised, recruiting), Austria (authorised, recruitment pending).
Therapeutic area(s): Diseases [C] - Nutritional and Metabolic Diseases [C18]
Gender: Female, Male. Age: 18-64 years, 65+ years. Enrolment: 210.
Start date (EU): 2026-07-22. Decision date: 2026-06-12. Results received: No. Last updated: 2026-06-22.
Decision dates by country: AT: 2026-06-14, BE: 2026-06-12, BG: 2026-06-22, FR: 2026-06-16, DE: 2026-06-12, GR: 2026-06-12, IT: 2026-06-17, ES: 2026-06-15, NL: 2026-06-15, PL: 2026-06-18

Condition(s): Metabolic Dysfunction-Associated Steatohepatitis (MASH)
Product: Placebo for Efimosfermin alfa

Primary endpoint: For all participants at Week 52, incidence and severity of TEAEs., For all participants at Week 52, incidence and severity of TEAEs leading to discontinuation., For all participants at Week 52, incidence of Grade 3 and Grade 4 laboratory abnormalities.
Endpoint(s): Absolute and relative change from baseline to Week 52 in ELF score for all participants., Achieving an improvement in ELF score of ≥ 0.5., Absolute and relative change from baseline to Week 52 in VCTE-LSM scores for all participants., Achieving a change from baseline in VCTE-LSM ≥ 30% at Week 52., Absolute and relative change from baseline to Week 52 in the subset of participants with MRE scores., Absolute and relative change from baseline to Week 52 in HFF by MRI-PDFF for all participants., Absolute and relative change from baseline to Week 52 in ALT, AST, and ALT/AST ratio for all participants., Achieving ALT and HFF normalization at Week 52., Achieving HFF ≤ 5% at Week 52., Change from baseline to Week 52 in HbA1c for participants with T2DM., Change from baseline to Week 52 in body weight for all participants., Change from baseline in fasting total cholesterol, LDL-C, HDL-C, and fasting triglycerides at Week 52 for all participants., Incidence of ADAs at Week 52., Efimosfermin serum concentrations in participants with PK data following multiple doses.

Source: https://euclinicaltrials.eu/ctis-public/view/2025-523674-16-00